EU clinical trial 2025-523107-30-01: Women victims of violences : PTSD treatment by traumatic memory reactivation under the influence of propranolol (VIOFEM)
Protocol code: RC31/23/0434
Sponsor: Centre Hospitalier Universitaire De Toulouse (Hospital/Clinic/Other health care facility). Phase: Therapeutic confirmatory (Phase III). Countries: France (authorised, recruitment pending).
Therapeutic area(s): Psychiatry and Psychology [F] - Mental Disorders [F03]
Gender: Female. Age: 18-64 years, 65+ years. Enrolment: 76.
Status: Authorised, recruitment pending. Decision date: 2026-06-24. Results received: No. Last updated: 2026-06-24.

Condition(s): Post-traumatic stress disorder (PTSD)
Product: PROPRANOLOL ARROW 40 mg, comprimé pelliculé sécable

Primary endpoint: PTSD symptom score at the Clinician Administered PTSD Scale for DSM-5/CAPS-5 (Rivest-Beauregard et al., 2022) administered one week/S7 after the 6th and last PPNL session and one week/S9 after the 8th and last PE session.
Endpoint(s): In order to evaluate the effect of 6 PPNL sessions compared to 6 PE sessions, the judgment criterion will be the quantitative variable corresponding for each subject to the PTSD symptom score at CAPS-5 administered one week/S7 after the 6th treatment session., STABILITY OF THE TREATMENT EFFECT In order to evaluate the stability of the effect of the 6 treatment sessions 3 and 6 months after the 6th session, a secondary endpoint will be the quantitative variable corresponding to the PTSD symptom score at CAPS-5 at S1, at M3, and at M6., PERCENTAGE OF NON-REMISSION In order to evaluate the percentage of non-remission after 6 treatment sessions, 1 week, 3 and 6 months after the 6th treatment session, a secondary endpoint will be the percentage of patients with a clinical diagnosis of PTSD 1 week, 3 and 6 months after the last treatment session, as recommended by DSM-5 and evaluated using CAPS-5., SYMPTOMS OF DEPRESSION In order to evaluate the effect of the 6 treatment sessions on comorbid depression symptoms, 1 week, 3 and 6 months after the 6th session, a secondary endpoint will be the quantitative variable corresponding to the depression symptom score at Beck Depression Inventory version II 21 items (BDI-II; Beck et al., 1998) at S7, M3 and M6., DISSOCIATIVE SYMPTOMS In order to evaluate the effect of 6 treatment sessions on comorbid dissociative symptoms, 1 week, 3 and 6 months after the 6th session, a secondary outcome will be the quantitative variable corresponding to the score of dissociative symptoms on the Dissociative Experiences Scale. (DES; Darves-Bornoz et al., 1999) to S7, M3 and M6., SUICIDAL IDEATION In order to evaluate the effect of the 6 treatment sessions on suicidal ideation, 1 week, 3 and 6 months after the 6th session, a secondary endpoint will be the quantitative variable corresponding to the score on the subscale suicide ideation of the Columbia scale-Suicide Severity Rating Scale (C-SSRS) (Posner et al., 2011) at S7, M3 and M6., Adverse effects : In order to assess the safety of the treatment, adverse events (AEs) and serious AEs occurring during the 6-month follow-up period will be recorded., FUNCTIONAL IMPROVEMENT In order to evaluate the effect of the 6 treatment sessions on the participant’s functional improvement, at the end of the 6th session and 3 months and 6 months later, a secondary endpoint will be the quantitative variable corresponding to the Clinical Global score. Impression Improvement Scale (CGI-I, Busner et al., 2007) at M3 and M6., QUALITY OF LIFE With the aim of evaluating the effect of the 6 treatment sessions on the quality of life of the participants, 1 week, 3 months and 6 months after the 6th treatment session, a secondary judgment criterion will be the corresponding quantitative variable auscore of the World Health Organization Quality of Life Brief (WHOQUOL, The WHOQOL Group, 1998) translated into French, at S7, M3 and M6., In order to assess the effect of 6 PPNL sessions compared to 8 PE sessions on the perceived intensity of PTSD symptoms, the judgment criterion will be the quantitative variable corresponding to the score measured by the PCL self-questionnaire.5 administered one week/S7 after the 6th and last PPNL session and one week/S9 after the 8th and last PE session.

Source: https://euclinicaltrials.eu/ctis-public/view/2025-523107-30-01